EU clinical trial 2024-515199-10-01: A Double-masked, Randomized, Sham-Controlled Study to Evaluate the Efficacy, Safety and Tolerability of Ultevursen in Subjects with Retinitis Pigmentosa (RP) due to Mutations in Exon 13 of the USH2A Gene
Protocol code: SB-421a-006
Sponsor: Laboratoires Thea (Pharmaceutical company). Phase: Therapeutic exploratory (Phase II). Countries: France (ongoing, recruitment ended), Belgium (ongoing, recruitment ended), Netherlands (ongoing, recruitment ended), Germany (ongoing, recruitment ended), Denmark (ongoing, recruitment ended), Italy (ongoing, recruitment ended).
Therapeutic area(s): Diseases [C] - Eye Diseases [C11]
Gender: Female, Male. Age: 0-17 years, 18-64 years, 65+ years. Enrolment: 31.
Status: Ongoing, recruitment ended. Start date (EU): 2025-09-29. Decision date: 2025-08-19. Results received: No. Last updated: 2026-06-12.
Decision dates by country: DE: 2025-08-20, NL: 2025-08-27, FR: 2025-08-19, DK: 2025-09-02, BE: 2025-08-26, IT: 2025-08-21

Condition(s): Retinitis Pigmentosa
Product: sham group will undergo a procedure that will closely mimic the active injection but with no penetration of the globe.

Primary endpoint: Annualized percent change from baseline in EZ width as measured by spectral-domain optical coherence tomography (SD-OCT) up to Month 24.
Endpoint(s): Efficacy: The following endpoints will be evaluated at Months 12 and 24, and as annualized change with data up to 24 months, unless otherwise specified: (Annualized) change from baseline in static perimetry (SP) mean sensitivity, Efficacy: The following endpoints will be evaluated at Months 12 and 24, and as annualized change with data up to 24 months, unless otherwise specified: (Annualized) change from baseline in microperimetry (MP) mean sensitivity, Efficacy: The following endpoints will be evaluated at Months 12 and 24, and as annualized change with data up to 24 months, unless otherwise specified: (Annualized) change from baseline in retinal sensitivity in at least 5 pre-specified loci in SP, Efficacy: The following endpoints will be evaluated at Months 12 and 24, and as annualized change with data up to 24 months, unless otherwise specified: (Annualized) change from baseline in retinal sensitivity in at least 5 pre-specified loci in MP, Efficacy: The following endpoints will be evaluated at Months 12 and 24, and as annualized change with data up to 24 months, unless otherwise specified: (Annualized) change from baseline in low luminance visual acuity (LLVA) using the Early Treatment Diabetic Retinopathy Study (ETDRS) chart, Efficacy: The following endpoints will be evaluated at Months 12 and 24, and as annualized change with data up to 24 months, unless otherwise specified: (Annualized) change from baseline in best-corrected visual acuity (BCVA) using the ETDRS chart, Efficacy: The following endpoints will be evaluated at Months 12 and 24, and as annualized change with data up to 24 months, unless otherwise specified: (Annualized) percent change from baseline in EZ area by SDOCT, Efficacy: The following endpoints will be evaluated at Months 12 and 24, and as annualized change with data up to 24 months, unless otherwise specified: Percent change from baseline in EZ width by SD-OCT, Efficacy: Evaluated at Months 12 and 24, and as annualized change with data up to 24 months: (Annualized) change from baseline in each domain of the following PROs (for subjects ≥13 years of age): Michigan Retinal Degeneration Questionnaire (MRDQ) scores in central vision, color vision, contrast sensitivity, scotopic function, photopic peripheral vision, mesopic peripheral vision, and photosensitivity, Efficacy: Evaluated at Months 12 and 24, and as annualized change with data up to 24 months: (Annualized) change from baseline in each domain of the following PROs (for subjects ≥13 years of age): Michigan Vision-Related Anxiety Questionnaire (MVAQ) scores in rod-function anxiety and cone-function anxiety, Safety and Tolerability: Frequency and severity of ocular and non-ocular adverse events (AEs), Systemic Exposure: Systemic serum concentration of ultevursen.

Source: https://euclinicaltrials.eu/ctis-public/view/2024-515199-10-01